EU clinical trial 2024-515811-22-00: Exploratory study on the impact of different doses and route of administration of exogenous progesterone in artificial endometrial preparation cycles on endometrial structure and function
Protocol code: 1901-VLC-014-EL
Sponsor: Ivi Valencia S.L. (Hospital/Clinic/Other health care facility). Phase: Therapeutic exploratory (Phase II). Countries: Spain (ended).
Therapeutic area(s): Diseases [C] - Female Urogenital Diseases and Pregnancy Complications [C13]
Gender: Female. Age: 18-64 years. Enrolment: 108.
Status: Ended. Start date (EU): 2021-10-10. End date (EU): 2025-03-31. Decision date: 2024-07-22. Results received: No. Last updated: 2024-07-22.

Condition(s): Female Infertility
Product: PRONTOGEST 100 mg/ml soluzione iniettabile, Prolutex 25 mg solución inyectable en jeringa precargada., Seidigestan 200 mg cápsulas blandas

Primary endpoint: - Gene expression for the whole transcriptome (22000 genes) related to progesterone treatments response in the window of implantation. - Number of differential expressed genes between P treatment groups in comparison with its natural cycle

Source: https://euclinicaltrials.eu/ctis-public/view/2024-515811-22-00